EU clinical trial 2025-522983-33-00: A double-blinded extension study to evaluate the long-term safety and tolerability of itepekimab in adult participants with inadequately controlled chronic rhinosinusitis with nasal polyps (CRSwNP) who participated in either EFC18418 or EFC18419 clinical studies
Protocol code: LTS18420
Sponsor: Sanofi-Aventis Recherche & Developpement (Pharmaceutical company). Phase: Therapeutic confirmatory (Phase III). Countries: Germany (ended), Netherlands (ended), Portugal (ended), Denmark (ended), Sweden (ended), Finland (ended), France (ended), Spain (ended), Austria (ended), Italy (ended), Hungary (ongoing, recruiting), Romania (ended), Belgium (ended), Czechia (ongoing, recruiting), Poland (ongoing, recruiting).
Therapeutic area(s): Diseases [C] - Respiratory Tract Diseases [C08]
Gender: Female, Male. Age: 18-64 years, 65+ years. Enrolment: 146.
Start date (EU): 2026-06-23. Decision date: 2026-05-11. Results received: No. Last updated: 2026-08-04.
Decision dates by country: BE: 2026-05-12, DK: 2026-05-11, FI: 2026-05-11, FR: 2026-05-11, HU: 2026-05-15, IT: 2026-05-14, RO: 2026-05-18, ES: 2026-05-14, SE: 2026-05-11, PT: 2026-05-12, AT: 2026-05-17, PL: 2026-05-15, DE: 2026-05-12, NL: 2026-05-13, CZ: 2026-05-13

Condition(s): Chronic rhinosinusitis with nasal polyps
Product: Itepekimab, Matched placebo for test product

Primary endpoint: Incidence of treatment-emergent adverse events (AEs), adverse events of special interest (AESIs), serious adverse events (SAEs), AEs leading to death, and AEs leading to permanent treatment discontinuation
Endpoint(s): Change from baseline of the parent studies (EFC18418, EFC18419) in endoscopic NPS, Change from baseline of the parent studies (EFC18418, EFC18419) in NCS, Functional itepekimab concentration in serum, Incidence of treatment-emergent anti-drug antibody (ADA) responses, Proportion of participants with CRSwNP requiring systemic corticosteroid(s) (SCS) or surgery for chronic rhinosinusitis (CRS), Annualized rate of SCS course or surgery for CRS

Source: https://euclinicaltrials.eu/ctis-public/view/2025-522983-33-00